EU clinical trial 2026-525643-32-00: STOP - Safety and efficacy of a STOPping strategy versus classical maintenance dose of JAK inhibitors in deep remission patients with ulcerative colitis: a randomized controlled trial
Sponsor: Centre Hospitalier Regional De Marseille (Hospital/Clinic/Other health care facility). Phase: Therapeutic use (Phase IV). Countries: France (authorised, recruitment pending).
Therapeutic area(s): Diseases [C] - Digestive System Diseases [C06]
Gender: Female, Male. Age: 18-64 years, 65+ years. Enrolment: 224.
Status: Authorised, recruitment pending. Decision date: 2026-06-17. Results received: No. Last updated: 2026-06-17.

Condition(s): ulcerative colitis
Product: Jyseleca 200 mg film-coated tablets, XELJANZ 5 mg film-coated tablets, RINVOQ 45 mg prolonged-release tablets

Primary endpoint: The primary endpoint of this study will be a composite criterion of treatment safety, efficacy, and patient satisfaction during the first 52 weeks of the follow-up. The order of the endpoints corresponds to the order of the component used in the statistical test.
Endpoint(s): a. Safety: occurrence of herpes zoster, infection, cardiovascular event, biochemical parameter, malignancies, adverse event leading to discontinuation, and all adverse events (serious or not) during the whole follow-up., b. Remission rate at the end the first 52 weeks of the follow-up., c. The area under the curve of the four dimensions of the TSQM 1.4: efficacy, side-effects, convenience, and global satisfaction; during the first 52 weeks post randomization and during the 104 weeks of follow-up., d. Treatment success at the end of the first 52 weeks and after 104 weeks of follow-up: absence of occurrence of failure criteria, e. Partial Mayo score at each visit of the entire follow-up (time-dependent pattern of change during the study), f. Number of days spent in steroid-free clinical remission, without surgery or change of treatment at the end the first 52 weeks of the follow-up. After treatment failure, this number of days will be zero., g. Number of days under treatment and cumulative dose of treatment per patient between randomization and primary endpoint (to consider in case of reach the primary endpoint)., h. Number of days under induction dose of JAK inhibitor at the end the first 52 weeks of the follow-up., i. Quality of life with SIBDQ, with IBD-DI, with SF-36 after 52 weeks and after 104 weeks of follow-up., j. Mayo endoscopic subscore at week 52 and week 104, k. Proportion of patients relapsing for each arm, l. Collect patient reported outcomes, endoscopic and biological data to draw a relationship between them.

Source: https://euclinicaltrials.eu/ctis-public/view/2026-525643-32-00